EU clinical trial 2023-504774-38-00: A Phase III, Randomized, Double-Blind, Placebo-Controlled, Multicenter Study to Evaluate the Efficacy and Safety of Obinutuzumab in Patients with Systemic Lupus Erythematosus
Protocol code: CA42750
Sponsor: F. Hoffmann-La Roche AG (Pharmaceutical company). Phase: Therapeutic confirmatory (Phase III). Countries: France (ongoing, recruitment ended), Poland (ongoing, recruitment ended), Italy (ongoing, recruitment ended), Czechia (ongoing, recruitment ended), Spain (ended).
Therapeutic area(s): Diseases [C] - Immune System Diseases [C20]; Phenomena and Processes [G] - Immune system processes [G12]
Gender: Female, Male. Age: 18-64 years, 65+ years. Enrolment: 68.
Start date (EU): 2021-11-04. Decision date: 2024-03-21. Results received: No. Last updated: 2026-02-11.
Decision dates by country: CZ: 2024-03-22, FR: 2024-03-21, ES: 2024-03-21, PL: 2024-03-25, IT: 2024-03-28

Condition(s): Systemic Lupus Erythematosus (SLE)
Product: Gazyva Placebo, Gazyvaro 1,000 mg concentrate for solution for infusion.

Primary endpoint: 1. Proportion of participants who achieve Systemic Lupus Erythematosus Responder Index (SRI)(4) at Week 52
Endpoint(s): 1. Proportion of participants who achieve SRI(6) at Week 52, 2. Proportion of participants entering the study on prednisone ≥ 10 mg/day (or equivalent) who achieve Sustained Corticosteroid Control from Week 40 through Week 52, 3. Time to first BILAG flare over 52 weeks, 4. Proportion of participants who achieve Sustained SRI(4) response from Week 40 through Week 52, 5. Proportion of participants who achieve British Isles Lupus Assessment Group-based Composite Lupus Assessment (BICLA) at Week 52, 6. Proportion of participants who achieve SRI(4) at Week 24, 7. Proportion of participants who achieve clinical SRI(4) at Week 52, 8. Proportion of participants who achieve SRI(4) at Week 52 on low-dose corticosteroids, 9. Proportion of participants who achieve Lupus Low Disease Activity State (LLDAS) at Week 52, 10. Proportion of participants who achieve Definition of Remission in SLE (DORIS) at Week 52, 11. Change in Functional Assessment of Chronic Illness Therapy−Fatigue (FACIT-F) scale from baseline to Week 24 and from baseline to Week 52, 12. Change in 36-Item Short Form Survey, Version 2 (SF-36 v2) Bodily Pain domain scale from baseline to Week 24 and from baseline to Week 52, 13. Change in SF-36 v2 Physical Component Summary scale from baseline to Week 24 and from baseline to Week 52, 14. Change in active joint count (swollen plus tender) from baseline to Week 24 and from baseline to Week 52, 15. Proportion of participants who achieve a ≥50% reduction in active joint counts (swollen plus tender) at each study visit, 16. Proportion of participants who achieve a ≥50% reduction in Cutaneous Lupus Erythematosus Disease Area and Severity (CLASI) Total Activity Score at each study visit, among Participants with CLASI Total Activity Score ≥10 at Baseline, 17. Proportion of participants who achieve sustained corticosteroid control from Week 40 through Week 52, 18. Cumulative corticosteroid use (in equivalent milligrams of prednisone) through Week 52, 19. Incidence and severity of adverse events, 20. Characterization of adverse events of special interest, 21. Change from baseline in targeted vital signs, 22. Change from baseline in targeted clinical laboratory test results, 23. Serum concentrations of obinutuzumab at specified timepoints, 24. Prevalence of ADAs at baseline and incidence of ADAs during the study

Source: https://euclinicaltrials.eu/ctis-public/view/2023-504774-38-00